EU clinical trial 2024-520213-45-00: Safety and Preliminary Clinical Efficacy of MT-302 with CapOx based regimens in metastatic esophagogastric cancer (SPaCE-MT)
Sponsor: Amsterdam UMC Stichting (Patient organisation/association). Phase: Phase I and Phase II (Integrated)- Other. Countries: Netherlands (ongoing, recruiting).
Therapeutic area(s): Diseases [C] - Neoplasms [C04]
Gender: Female, Male. Age: 18-64 years, 65+ years. Enrolment: 61.
Status: Ongoing, recruiting. Start date (EU): 2025-08-15. Decision date: 2025-07-01. Results received: No. Last updated: 2026-04-09.

Condition(s): metastatic esophagogastric cancer

Source: https://euclinicaltrials.eu/ctis-public/view/2024-520213-45-00